EU clinical trial 2023-508123-12-00: Safety and efficacy of anakinra treatment for patients with persistent respiratory symptoms post acute covid and immune system activation: the PRECISION double-blind, randomized clinical trial
Protocol code: PRECISION
Sponsor: Hellenic Institute For The Study Of Sepsis (Laboratory/Research/Testing facility). Phase: Phase II and Phase III (Integrated). Countries: Greece (authorised, recruiting), Germany (authorised, recruitment pending), Italy (authorised, recruitment pending), Spain (authorised, recruitment pending).
Therapeutic area(s): Diseases [C] - Respiratory Tract Diseases [C08]; Diseases [C] - Immune System Diseases [C20]
Gender: Female, Male. Age: 18-64 years, 65+ years. Enrolment: 302.
Start date (EU): 2023-11-03. Decision date: 2023-11-03. Results received: No. Last updated: 2026-05-13.
Decision dates by country: IT: 2024-12-16, ES: 2025-05-20, DE: 2024-12-23, GR: 2023-11-03

Condition(s): Post-Acute COVID Syndrome (PACS)
Product: Kineret 100 mg/0.67 ml solution for injection in pre-filled syringe., KINERET Placebo sol inj 0 mg 0,67 ml syringe for clinical packaging

Primary endpoint: A positive score is achieved when both of the Conditions A and B are completed. The conditions A and B are explicitly explained in the study protocol.
Endpoint(s): The frequency of the Score of PACS progression reversal between patients receiving 8 weeks anakinra treatment compared to patients receiving 4 weeks anakinra treatment (+4 weeks of placebo), Changes in cytokine production capacity of stimulated PBMCs at week 4 between the two arms of treatment, Change of each component of the score for the primary outcome at week 4 between the two arms of treatment, At least 10% decrease of the pulmonary artery pressure at week 4 between the two arms of treatment, At least 10% increase of LV ejection fraction (if abnormal at baseline) at week 4 between the two arms of treatment, The number of meters walked during the 6-min walk test between the two arms of treatment at week 4, The number of meters walked during the 6-min walk test between patients receiving 8 weeks anakinra treatment compared to patients receiving 4 weeks anakinra treatment, Number of criteria of the Condition A met, Safety of anakinra

Source: https://euclinicaltrials.eu/ctis-public/view/2023-508123-12-00